EU clinical trial 2024-518115-19-02: A single-centre, partially blind, randomised, parallel-group, two-arms, superiority study to compare the efficacy and safety of extended (3 h) and intermittent infusion (0.5 h) of β-lactams (cefepime, ceftriaxone, meropenem, piperacillin/tazobactam) in critically ill paediatric patients (PEBBLE)
Protocol code: PEBBLE
Sponsor: Semmelweis University (Educational Institution). Phase: Therapeutic use (Phase IV). Countries: Hungary (authorised, recruitment pending).
Therapeutic area(s): Diseases [C] - Bacterial Infections and Mycoses [C01]
Gender: Female, Male. Age: 0-17 years. Enrolment: 110.
Status: Authorised, recruitment pending. Decision date: 2025-07-24. Results received: No. Last updated: 2025-09-29.

Condition(s): suspected or proven infection, critical illness
Product: Meropenem Qilu 1 g por oldatos injekcióhoz/infúzióhoz, Meropenem Kalceks 1 g por oldatos injekcióhoz vagy infúzióhoz, Piperacillin/Tazobactam Kabi 4 g/0,5 g por oldatos infúzióhoz, Ceftriaxon MIP 1 g por oldatos injekcióhoz vagy infúzióhoz, Ceftriaxon MIP 2 g por oldatos infúzióhoz, Meropenem Steriscience 1000 mg por oldatos injekciohoz vagy infuziohoz, Piperacillin/Tazobactam Kabi 4 g/0,5 g por oldatos infúzióhoz, Meropenem Qilu 1 g por oldatos injekcióhoz/infúzióhoz, Meropenem Qilu 500 mg por oldatos injekcióhoz/infúzióhoz, Cefepim AptaPharma 2 g por oldatos injekcióhoz vagy infúzióhoz, Meropenem Qilu 1 g por oldatos injekcióhoz/infúzióhoz, Ceftriaxon MIP 1 g por oldatos injekcióhoz vagy infúzióhoz, Meropenem Kabi 1 g por oldatos injekcióhoz vagy infúzióhoz, Ceftriaxone Qilu 1 g por oldatos injekcióhoz vagy infúzióhoz, Ceftriaxon AptaPharma 2 g por oldatos injekcióhoz vagy infúzióhoz, Meropenem Kabi 1 g por oldatos injekcióhoz vagy infúzióhoz, Meropenem Kabi 500 mg por oldatos injekcióhoz vagy infúzióhoz, Ceftriaxone Kalceks 2 g por oldatos injekcióhoz vagy inf?zióhoz, Ceftriaxon MIP 1 g por oldatos injekcióhoz vagy infúzióhoz, Ceftriaxone Qilu 2 g por oldatos injekcióhoz vagy infúzióhoz, Piperacillin/Tazobactam Sandoz 4 g/0,5 g por oldatos infúzióhoz, Cefepim AptaPharma 2 g por oldatos injekcióhoz vagy infúzióhoz, Piperacillin/Tazobactam Sandoz 4 g/0,5 g por oldatos infúzióhoz, Meropenem Steriscience 500 mg por oldatos injekciohoz vagy infuziohoz, Ceftriaxon Kabi 1 g por oldatos injekcióhoz vagy infúzióhoz, Piperacillin/Tazobactam Kabi 4 g/0,5 g por oldatos infúzióhoz, Ceftriaxon AptaPharma 1 g por oldatos injekcióhoz vagy infúzióhoz, Ceftriaxone Qilu 1 g por oldatos injekcióhoz vagy infúzióhoz, Cefepim AptaPharma 1 g por oldatos injekcióhoz vagy infúzióhoz, Meropenem AptaPharma 1000 mg por oldatos injekcióhoz vagy infúzióhoz, Ceftriaxone Qilu 2 g por oldatos injekcióhoz vagy infúzióhoz, Piperacillin/Tazobactam Sandoz 4 g/0,5 g por oldatos infúzióhoz, Ceftriaxon MIP 2 g por oldatos infúzióhoz, Meropenem Kabi 1 g por oldatos injekcióhoz vagy infúzióhoz, Meropenem Kalceks 500 mg por oldatos injekcióhoz vagy infúzióhoz, Piperacillin/Tazobactam Sandoz 4 g/0,5 g por oldatos infúzióhoz, Ceftriaxone Kalceks 1 g por oldatos injekcióhoz vagy infúzióhoz, Ceftriaxone Qilu 2 g por oldatos injekcióhoz vagy infúzióhoz, Meropenem AptaPharma 500 mg por oldatos injekcióhoz vagy infúzióhoz, Ceftriaxone Kalceks 1 g por oldatos injekcióhoz vagy infúzióhoz, Piperacillin/Tazobactam Sandoz 4 g/0,5 g por oldatos infúzióhoz, Ceftriaxone Qilu 1 g por oldatos injekcióhoz vagy infúzióhoz, Ceftriaxon Kabi 1 g por oldatos injekcióhoz vagy infúzióhoz, Piperacillin/Tazobactam Kalceks 4 g/0,5 g por oldatos infúzióhoz, Meropenem Kalceks 500 mg por oldatos injekcióhoz vagy infúzióhoz, Meropenem Kalceks 1 g por oldatos injekcióhoz vagy infúzióhoz, Ceftriaxon Kabi 2 g por oldatos infúzióhoz , Cefepim AptaPharma 2 g por oldatos injekcióhoz vagy infúzióhoz, Cefepim AptaPharma 1 g por oldatos injekcióhoz vagy infúzióhoz, Ceftriaxon MIP 2 g por oldatos infúzióhoz, Meropenem Kabi 1 g por oldatos injekcióhoz vagy infúzióhoz, Cefepim AptaPharma 1 g por oldatos injekcióhoz vagy infúzióhoz, Meropenem AptaPharma 1000 mg por oldatos injekcióhoz vagy infúzióhoz, Meropenem AptaPharma 500 mg por oldatos injekcióhoz vagy infúzióhoz, Meropenem AptaPharma 2000 mg por oldatos infúzióhoz, Piperacillin/Tazobactam Kalceks 4 g/0,5 g por oldatos infúzióhoz, Meropenem Kabi 1 g por oldatos injekcióhoz vagy infúzióhoz, Ceftriaxon Kabi 2 g por oldatos infúzióhoz , Meropenem Kabi 1 g por oldatos injekcióhoz vagy infúzióhoz, Meropenem Pharmacenter 500 mg por oldatos injekcióhoz vagy infúzióhoz, Meropenem Kabi 500 mg por oldatos injekcióhoz vagy infúzióhoz, Ceftriaxone Kalceks 2 g por oldatos injekcióhoz vagy inf?zióhoz, Ceftriaxon AptaPharma 2 g por oldatos injekcióhoz vagy infúzióhoz, Meropenem Pharmacenter 1 g por oldatos injekcióhoz vagy infúzióhoz, Meropenem Qilu 500 mg por oldatos injekcióhoz/infúzióhoz

Primary endpoint: The proportion of patients achieving the therapeutic and optimal exposure when the plasma concentrations are above the MIC for 100% of the dosing interval. Trough plasma concentration levels will be measured.
Endpoint(s): The proportion of patients achieving PK/PD index: 100% fT>4xMIC (Ctrough >4xMIC), CRP normalisation (days, <10 mg/L), PCT normalisation (days, <0.5), WBC normalisation (days, <10000 /µl), All-cause mortality (within 30 days or until hospital discharge), Adverse events (every day), Microbiological eradication rate (in different time points: 1st day, 2nd day, 3rd day, 5th day), Clinical response (resolution or improvement or failure), Clinical success (Time in days when clinical succes or resolution is achieved), Treatment failure (Number of patients, for whom the β-lactam antibiotic had to be stopped due to the clinical deterioration and/or antibiotic resistance.), Duration of the antibiotic (days), Length of PICU/NICU stay (days), Length of hospital stay (LOS) (days)

Source: https://euclinicaltrials.eu/ctis-public/view/2024-518115-19-02